EU clinical trial 2022-502417-28-01: SARA-31: A phase 3 trial to evaluate the efficacy and safety of BIO-101 in elderly patients suffering from severe SARcopeniA: an interventional, randomized double-blind placebo- controlled, clinical trial.
Protocol code: BIO101-CL07
Sponsor: Biophytis (Pharmaceutical company). Phase: Therapeutic confirmatory (Phase III). Countries: Belgium (authorised, recruitment pending).
Therapeutic area(s): Diseases [C] - Musculoskeletal Diseases [C05]
Gender: Female, Male. Age: 65+ years. Enrolment: 50.
Status: Authorised, recruitment pending. Decision date: 2025-08-13. Results received: No. Last updated: 2025-08-13.

Condition(s): Sarcopenia
Product: Placebo hard capsules, 20-hydroxyecdysone

Primary endpoint: Time to onset of Major Mobility Disability (MMD)
Endpoint(s): Gait speed 4-m from Short Physical Performance Battery SSPB Change from Baseline (CFB) at week 52, Handgrip Strength (HGS) CFB at week 52, Sarcopenia – Quality of Life (SarQol) Patient Reported Outcome (PRO) CFB at week 52

Source: https://euclinicaltrials.eu/ctis-public/view/2022-502417-28-01